EU clinical trial 2024-515593-27-00: A Phase 3 Randomized Double-Blind Multicenter Study of Sonrotoclax Plus Zanubrutinib Versus Placebo Plus Zanubrutinib in Patients With Relapsed/Refractory Mantle Cell Lymphoma
Protocol code: BGB-11417-302
Sponsor: BeOne Medicines AG (Pharmaceutical company). Phase: Therapeutic confirmatory (Phase III). Countries: Germany (ongoing, recruiting), France (ongoing, recruiting), Italy (ongoing, recruiting), Poland (ongoing, recruitment ended), Spain (ongoing, recruiting), Austria (ongoing, recruiting).
Therapeutic area(s): Diseases [C] - Neoplasms [C04]
Gender: Female, Male. Age: 18-64 years, 65+ years. Enrolment: 140.
Start date (EU): 2025-05-08. Decision date: 2025-04-21. Results received: No. Last updated: 2026-07-06.
Decision dates by country: AT: 2025-04-28, FR: 2025-04-22, IT: 2025-04-22, ES: 2025-04-21, PL: 2025-04-27, DE: 2025-04-23

Condition(s): relapsed or refractory mantle cell lymphoma (R/R MCL)
Product: BGB-11417, Zanubrutinib, BGB-11417, BGB-11417 placebo, BGB-11417, BGB-11417

Primary endpoint: Progression-free survival (PFS), as assessed by blinded independent review committee (BIRC), defined as the time from randomization to the date of progression or death, whichever occurs first.
Endpoint(s): Overall survival (OS), defined as the time from randomization to the date of death from any cause., Progression-free survival (PFS) as determined by investigator., Overall response rate (ORR) as determined by BIRC and by investigator per the Lugano 2014 criteria. ORR is defined as the proportion of patients who achieved a best overall response of partial response or complete response (CR)., Duration of response (DOR) as determined by BIRC and by investigator. It is defined as the time from the first qualifying response to the date of progression or death, whichever occurs first., Complete response rate (CRR), as determined by BIRC and by investigator. It is defined as the proportion of patients who achieved a best overall response of CR., Time to first response as determined by BIRC and by investigator. It is defined as time from randomization to first response., Time to initiation of new anticancer therapy., Patient-reported symptom burden and physical condition/fatigue as measured by the European Organisation of Research and Treatment of Cancer-Quality of Life Questionnaire Non-Hodgkin Lymphoma High Grade Module 29 (EORTC-QLQ-NHL-HG29) questionnaire, and global health status (GHS) and physical function as measured by the European Organisation of Research and Treatment of Cancer-Quality of Life Questionnaire Core 30 (EORTC-QLQ-C30)., Incidence and severity of treatment-emergent adverse events (TEAE)s graded according to National Cancer Institute Common Terminology Criteria for Adverse Events (NCI-CTCAE) v5.0

Source: https://euclinicaltrials.eu/ctis-public/view/2024-515593-27-00